EU clinical trial 2025-523757-33-00: A Phase 2, Multicenter, Study to Evaluate the Pharmacokinetics and Safety of Subcutaneous Ublituximab Administered at Various Injection Sites and Relative Bioavailability via Autoinjector Device versus Syringe in Patients with Multiple Sclerosis
Protocol code: TG1101-RMS-SC201
Sponsor: Tg Therapeutics Inc. (Pharmaceutical company). Phase: Therapeutic exploratory (Phase II). Countries: Poland (ongoing, recruiting).
Therapeutic area(s): Diseases [C] - Nervous System Diseases [C10]
Gender: Female, Male. Age: 18-64 years, 65+ years. Enrolment: 120.
Status: Ongoing, recruiting. Start date (EU): 2026-05-07. Decision date: 2026-04-03. Results received: No. Last updated: 2026-07-29.

Condition(s): multiple sclerosis
Product: Ublituximab

Primary endpoint: Incidence of treatment emergent adverse events (TEAE)
Endpoint(s): Incidence of TEAE

Source: https://euclinicaltrials.eu/ctis-public/view/2025-523757-33-00